EU clinical trial 2025-521340-37-00: A phase IIIb study of durvalumab as consolidation treatment for patients diagnosed with limited stage small cell lung cancer who have not progressed following definitive concurrent or sequential platinum-based chemoradiation therapy in Spain (ALBORAN).
Protocol code: D419QL00009
Sponsor: Astrazeneca Farmaceutica Spain S.A. (Pharmaceutical company). Phase: Therapeutic confirmatory (Phase III). Countries: Spain (ongoing, recruitment ended).
Therapeutic area(s): Diseases [C] - Neoplasms [C04]
Gender: Female, Male. Age: 18-64 years, 65+ years. Enrolment: 70.
Status: Ongoing, recruitment ended. Start date (EU): 2025-07-24. Decision date: 2025-07-16. Results received: No. Last updated: 2025-10-22.

Condition(s): small cell lung cancer
Product: IMFINZI 50 mg/mL concentrate for solution for infusion.

Primary endpoint: • Incidence of grade ≥ 3 AEs, • Incidence of imAE, defined as an AE that is associated with drug exposure and is consistent with an immune-mediated mechanism of action and there is no clear alternate etiology., • Incidence of AEs that lead to treatment delays/interruptions or permanent discontinuation.
Endpoint(s): • Progression-Free Survival (PFS). Progression-Free Survival defined as the time from the date of first dose of durvalumab until the date of objective disease progression according RECIST 1.1 criteria assessed by investigator, or death (by any cause in the absence of progression). The measure of interest is the median PFS., • Overall Survival (OS) rate at 36 months, defined as the percentage of patients that are still alive at 36 months., • All AEs., • Serious AEs., • Factors to be analysed: - Gender - Age range (<65 vs ≥65 years) - Smoking status - WHO/ECOG - PD-L1 status - Disease stage - Carboplatin vs cisplatin - Type of radiotherapy: standard vs hyperfractionated - cCRT vs sCRT - Response to CRT - Time to durvalumab initiation from last CRT dose - PCI, Scores on the EORTC (European Organisation for Research and Treatment of Cancer) Core Quality of Life Questionnaire (EORTC QLQ-C30) and its specific module for lung cancer QLQ-LC29. Change from baseline in EORTC QLQ-C30 and EORTC QLQ-LC29 and time to deterioration in EORTC QLQ-C30., Biomarker analysis of tumour tissue sample at baseline to assess exploratory markers, which may include but is not limited to PD-L expressions. Biomarker analysis of blood samples at baseline, during treatment and at the end of treatment/progression, which may include but are not limited to ctDNA.

Source: https://euclinicaltrials.eu/ctis-public/view/2025-521340-37-00